EU clinical trial 2022-501648-14-00: Long-Term Follow-up of Patients Treated with Miltenyi Cell and Gene Therapies
Protocol code: M-2022-393
Sponsor: Miltenyi Biomedicine GmbH (Pharmaceutical company). Phase: Phase I and Phase II (Integrated)- Other. Countries: Germany (ongoing, recruiting).
Therapeutic area(s): Diseases [C] - Neoplasms [C04]; Diseases [C] - Hemic and Lymphatic Diseases [C15]; Diseases [C] - Skin and Connective Tissue Diseases [C17]
Gender: Female, Male. Age: 0-17 years, 18-64 years, 65+ years. Enrolment: 40.
Status: Ongoing, recruiting. Start date (EU): 2024-05-05. Decision date: 2023-11-17. Results received: No. Last updated: 2026-02-19.

Condition(s): Relapsed or refractory CD19 positive B cell malignancies (adult ALL, adult NHL/chronic lymphatic leukemia [CLL]), Relapsed or refractory B cell non-Hodgkins lymphoma (NHL), Relapsed or refractory CD20 positive B-cell non-Hodgkin’s lymphoma (NHL), Unresectable stage III or IV melanoma, Relapsed or refractory CD19 positive B cell malignancies (pediatric acute lymphatic leukemia [ALL], aggressive NHL)
Product: MB-CART20.1, MB-CART2019.1, MB-CART19.1

Primary endpoint: Percentage of patients with late-onset adverse reactions (AR), serious adverse events (SAE), serious adverse reactions (SAR) and adverse events of special interest (AESI) including relapse or progression of the underlying disease, life-threatening infections, death due to any cause, new and secondary malignancies
Endpoint(s): B- and T-lymphocyte count, Height and weight, Tanner staging, menstruation status for pediatric patients, Percentage of patients with detectable replication-competent lentivirus (RCL) (if results of 2 consecutive years are negative for an individual patient, further sampling will not be continued for this patient; if results of all samples in first year of primary trial were negative for an individual patient, sampling will not be continued for this patient in this long-term follow-up trial), Percentage of patients who relapse or progress since enrollment and rate of surviving patients, Percentage of patients with detectable transgene levels (if results of 2 consecutive years are negative for an individual patient, further sampling will be stopped for this patient)

Source: https://euclinicaltrials.eu/ctis-public/view/2022-501648-14-00